EU clinical trial 2024-517902-27-00: Regression of Atherosclerosis induced by liFe chAnging Experience with psiLocybin
Protocol code: RAFAEL
Sponsor: Psyon s.r.o. (Hospital/Clinic/Other health care facility). Phase: Therapeutic exploratory (Phase II). Countries: Czechia (ongoing, recruiting).
Therapeutic area(s): Diseases [C] - Cardiovascular Diseases [C14]
Gender: Female, Male. Age: 18-64 years, 65+ years. Enrolment: 60.
Status: Ongoing, recruiting. Start date (EU): 2024-10-14. Decision date: 2024-11-21. Results received: No. Last updated: 2026-06-19.

Condition(s): Stable Ischemic Heart Disease
Product: Midazolam 1 mg, Psilocybine 5 mg

Primary endpoint: Change in the atherosclerotic plaque volume between the baseline (F2) and follow-up invasive coronary artery examination (F7) performed 365 days ± 28 days after IMP administration (F4) measured with intravascular ultrasound (IVUS).
Endpoint(s): Change in the composition of atherosclerotic plaques between the baseline (F2) and follow-up invasive coronary artery examination (F7) 365 days ± 28 days after IMP administration (F4), Reduction in the incidence of the thin-cap fibroatheroma (TCFA), between the baseline (F2) and follow-up invasive coronary artery examination (F7) performed 365 days ± 28 days after IMP administration (F4), Change in the increase of the in fibrous cap thickness measured with optical coherence tomography between the baseline (F2) and follow-up invasive coronary artery examination (F7) 365 days ± 28 days after IMP administration (F4), Safety evaluation (blood pressure, heart rate) of study medication

Source: https://euclinicaltrials.eu/ctis-public/view/2024-517902-27-00